EU clinical trial 2023-506035-15-00: RANDOMISED, CROSSOVER BIOEQUIVALENCE CLINICAL TRIAL OF APIXABAN 5 MG CAPSULES VS APIXABAN 5 MG FILM-COATED TABLETS, AFTER A SINGLE ORAL DOSE ADMINISTRATION TO HEALTHY VOLUNTEERS UNDER FASTING CONDITIONS
Protocol code: UECHUP-API/23-2
Sponsor: Laboratorios Alter S.A. (Pharmaceutical company). Phase: Human Pharmacology (Phase I)- Bioequivalence Study. Countries: Spain (ended).
Therapeutic area(s): Diseases [C] - Cardiovascular Diseases [C14]
Gender: Female, Male. Age: 18-64 years. Enrolment: 36.
Status: Ended. Start date (EU): 2023-08-16. End date (EU): 2023-09-19. Decision date: 2023-08-11. Results received: Yes. Last updated: 2023-08-11.

Condition(s): thrombosis
Product: Eliquis 5 mg film-coated tablets, Apixaban 5 mg Cápsula dura

Primary endpoint: AUC0-t and Cmax of apixaban
Endpoint(s): AUC0-∞, Tmax and residual area of apixaban

Source: https://euclinicaltrials.eu/ctis-public/view/2023-506035-15-00